EU clinical trial 2024-517488-22-00: Prediction and prevention of infantile spasms in high risk children
Sponsor: HUS-Yhtymae (Hospital/Clinic/Other health care facility). Phase: Therapeutic use (Phase IV). Countries: Finland (ongoing, recruiting).
Therapeutic area(s): Diseases [C] - Nervous System Diseases [C10]
Gender: Female, Male. Age: 0-17 years. Enrolment: 140.
Status: Ongoing, recruiting. Start date (EU): 2018-05-28. Decision date: 2024-09-13. Results received: No. Last updated: 2026-07-08.

Condition(s): Patients in high risk for infantile spasm syndrome (age under 1 yr old): -tuborous sclerosis (not after 11/2023); -large vascular cortical injury (large infarction/hemorrhage/infection/trauma, HIE II-III including MRI-criteria 2b and 3, with also cortical lesions; -grade IV intraventricular hemorrhage (including hemorrhagic infarct in brain parenchyma); -grade III-IV PVL (including porencephalic cyst) in preterms
Product: Sabrilex 500 mg rakeet oraaliliuosta varten

Primary endpoint: Efficacy: whether patient gets infantile spasm syndrome or not
Endpoint(s): Is there a difference between groups in neurocognitive development? Can eye tracking analysis predict EEG changes, neurocognitive development or onset of infantile spasm syndrome?

Source: https://euclinicaltrials.eu/ctis-public/view/2024-517488-22-00